EU clinical trial 2022-500439-35-00: A phase 3 multicentre, randomized, prospective, open-label trial of Ibrutinib monotherapy versus fixed-duration Venetoclax plus Obinutuzumab versus fixed-duration Venetoclax plus Ibrutinib in patients with previously untreated chronic lymphocytic leukaemia (CLL) - CLL17
Protocol code: CLL17
Sponsor: University Of Cologne (Educational Institution). Phase: Therapeutic confirmatory (Phase III). Countries: Denmark (ongoing, recruitment ended), Belgium (ongoing, recruitment ended), Austria (ongoing, recruitment ended), Germany (ongoing, recruitment ended), Netherlands (ongoing, recruitment ended), Ireland (ongoing, recruitment ended), Norway (ongoing, recruitment ended), Finland (ongoing, recruitment ended), Spain (ongoing, recruitment ended), Sweden (ongoing, recruitment ended), Italy (ongoing, recruitment ended).
Therapeutic area(s): Diseases [C] - Neoplasms [C04]
Gender: Female, Male. Age: 18-64 years, 65+ years. Enrolment: 841.
Status: Ongoing, recruitment ended. Start date (EU): 2021-02-11. Decision date: 2023-09-05. Results received: No. Last updated: 2026-07-14.
Decision dates by country: SE: 2023-09-05, NO: 2023-09-06, BE: 2023-09-06, IE: 2023-09-05, DK: 2023-09-05, AT: 2023-09-08, FI: 2023-09-08, NL: 2023-09-05, IT: 2023-09-14, ES: 2023-09-08, DE: 2023-09-11

Condition(s): treatment-naive chronic lymphocytic leukemia
Product: Venetoclax, IMBRUVICA 140 mg hard capsules, Venetoclax, Venetoclax, Gazyvaro 1,000 mg concentrate for solution for infusion.

Primary endpoint: Progression-free survival (PFS)
Endpoint(s): Rates of undetectable MRD (uMRD, i.e. <10E-4) in peripheral blood (PB) and bone marrow (BM) at final restaging (RE), which will be at cycle 18 after start of treatment, and additional BM assessment approx. 12 months after RE, MRD levels in PB at different time points (cycle 1 before start of ther-apy, start of cycle 7, start of cycle 13 [end of VG treatment], start of cycle 16 [end of VI treatment], final restaging [cycle 18], afterwards every 6 months to end of study), Duration of undetectable MRD (uMRD), Overall response rate (ORR; defined as rate of a response of CR, CRi, or PR) as per iwCLL guidelines at final restaging, Duration of response, Complete response rate (CRR; defined as rate of a response of CR or CRi) at final restaging as per iwCLL guidelines, Overall survival (OS), Event-free survival (EFS) (I vs VG and I vs VI), Time to next treatment (TTNT), PFS2 (i.e. PFS after second-line treatment)

Source: https://euclinicaltrials.eu/ctis-public/view/2022-500439-35-00